EU clinical trial 2024-511538-11-00: Clinical investigation evaluating safety and efficacy of selective intra-arterial 166Holmium radiation therapy in combination with atezolizumab and bevacizumab for non resectable Hepatocellular carcinoma (HOLMBRAVE)
Protocol code: 2021/3330 HOLMBRAVE
Sponsor: Institut Gustave Roussy (Hospital/Clinic/Other health care facility). Phase: Therapeutic exploratory (Phase II). Countries: France (ended).
Therapeutic area(s): Diseases [C] - Digestive System Diseases [C06]; Diseases [C] - Neoplasms [C04]
Gender: Female, Male. Age: 18-64 years, 65+ years. Enrolment: 40.
Status: Ended. Start date (EU): 2023-02-07. End date (EU): 2024-07-30. Decision date: 2024-04-05. Results received: Yes. Last updated: 2024-04-05.

Condition(s): Non resectable Hepatocellular carcinoma (HCC)
Product: Tecentriq 1 200 mg concentrate for solution for infusion, Pulmocis 2 mg trousse pour préparation radiopharmaceutique, Avastin 25 mg/ml concentrate for solution for infusion.

Primary endpoint: • Objective response rate (complete or partial response) at 6 months after 166Holmium SIRT according to mRECIST on contrast enhanced imaging (CT-scan and/or MRI)
Endpoint(s): • Objective Response Rate (ORR), PFS and OS at 12 weeks, at 6- and 12-months according to mRECIST criteria, but also itRECIST criteria., • Type, frequency and severity of treatment related adverse events (irAEs) and adverse device effects (ADEs)., • Identifying of predictive biomarkers of tumor response and adverse events (imaging and biological), • Determination of the immune checkpoints upregulated upon Atezolizumab/Bevacizumab therapy within tumors of primary and secondary resistant patients., • Assessment of the Increase in tumor infiltrating CD3+ lymphocytes, CD8+CD69+/FOXP3+ICOS+ T-cells, PDL1 expression, and the proportion of activated cells (CD80, CD86, HLA-II on CD16+, CD32+ and CD64+ myeloid cells)., • Assessment of the impact on angiogenic factors such as Tie2, Angiopoietine, VEGF, on both tumor and blood samples.

Source: https://euclinicaltrials.eu/ctis-public/view/2024-511538-11-00